EU clinical trial 2023-507798-16-00: A Phase II, Open-label, Single-arm Study of Osimertinib as Induction Therapy Prior to CRT and Maintenance Osimertinib in Patients with Epidermal Growth Factor Receptor (EGFR) Mutation-positive, Stage III, Unresectable Non-small Cell Lung Cancer (NEOLA)
Protocol code: D516AC00003
Sponsor: Astrazeneca AB (Pharmaceutical company). Phase: Therapeutic exploratory (Phase II). Countries: Spain (ongoing, recruitment ended).
Therapeutic area(s): Diseases [C] - Neoplasms [C04]
Gender: Female, Male. Age: 18-64 years, 65+ years. Enrolment: 16.
Status: Ongoing, recruitment ended. Start date (EU): 2024-04-16. Decision date: 2024-03-08. Results received: No. Last updated: 2025-04-28.

Condition(s): Unresectable Non-small Cell Lung Cancer
Product: Bendatax 6 mg/ ml, TAGRISSO 80 mg film-coated tablets, CISPLATIN, CARBOPLATIN, PEMETREXED, Cisplatin 1mg/ml Concentrate for Solution for Infusion, TAGRISSO 40 mg film-coated tablets, Armisarte 25 mg/ml concentrate for solution for infusion, Carboplatin 10 mg/ml concentrate for solution for infusion, PACLITAXEL

Primary endpoint: Outcome measure: PFS PFS is defined as the time from date of first dose until progression per RECIST 1.1 as assessed by the investigator at the local site, or death due to any cause. The analysis will include all dosed patients. The primary measure of interest is the proportion of patients alive and progression free at 12 months.
Endpoint(s): Outcome measure: ORR ORR is defined as the proportion of patients who have a CR or PR, as determined by the investigator at local site per RECIST 1.1. The analysis will include all dosed patients with measurable disease at baseline. The measure of interest is the estimate of ORR at end of induction phase after the 8 week scan., Outcome measure: DCR DCR is defined as the percentage of subjects who have a best overall response of CR or PR or SD (at 8 weeks) as determined by the investigator at the local site per RECIST 1.1. Data obtained from first dose until end of induction phase will be included in the assessment of DCR, regardless of whether a patient withdraws from therapy. The measure of interest is the estimate of DCR at the end of induction phase after the 8 week scan., Outcome measure: OS OS is defined as time from date of first dose until the date of death due to any cause. The analysis will include all dosed patients. All deaths will be included, regardless of whether the patient withdraws from therapy or receives another anticancer therapy. The measure of interest is the OS rate at 12 and 24 months., Outcome measure: EFS EFS is defined as time from date of first dose until any of the following events: progression of disease that precludes CRT or completion of CRT, progression during or after CRT, or death due to any cause. The analysis will include all dosed patients. All events will be included, regardless of whether the patient withdraws from therapy or receives another anticancer therapy. The measure of interest is the EFS rate at 12 months., Safety and tolerability will be evaluated in terms of AEs, vital signs, clinical laboratory testing, ECG, LVEF, and WHO performance status

Source: https://euclinicaltrials.eu/ctis-public/view/2023-507798-16-00